EU clinical trial 2023-506480-34-00: Gene Therapy for Danon Disease: A Phase 2 Study Evaluating the Efficacy and Safety of Intravenously Administered Adeno-Associated Virus Serotype 9 (rAAV9) Vector Containing the Human LAMP2 Isoform B Transgene (RP-A501; AAV9.LAMP2B) in Male Patients with Danon Disease
Protocol code: RP-A501-0123
Sponsor: Rocket Pharmaceuticals Inc. (Pharmaceutical company). Phase: Therapeutic exploratory (Phase II). Countries: Germany (ongoing, recruiting), Italy (ongoing, recruiting).
Therapeutic area(s): Diseases [C] - Congenital, Hereditary, and Neonatal Diseases and Abnormalities [C16]
Gender: Male. Age: 0-17 years, 18-64 years, 65+ years. Enrolment: 4.
Status: Ongoing, recruiting. Start date (EU): 2026-02-26. Decision date: 2024-01-19. Results received: No. Last updated: 2026-06-09.
Decision dates by country: IT: 2024-08-28, DE: 2024-01-19

Condition(s): Danon Disease
Product: Epysqli 300 mg concentrate for solution for infusion, RITUXIMAB, BEKEMV 300 mg concentrate for solution for infusion, SIROLIMUS, ECULIZUMAB, SIROLIMUS, PARACETAMOL, PREDNISONE, DIPHENHYDRAMINE HYDROCHLORIDE, AAV9.LAMP2B, DIPHENHYDRAMINE HYDROCHLORIDE, PREDNISONE, SIROLIMUS, SIROLIMUS, PREDNISONE, RITUXIMAB, METHYLPREDNISOLONE SODIUM SUCCINATE, METHYLPREDNISOLONE SODIUM SUCCINATE, PARACETAMOL, PREDNISONE, PREDNISONE, BEKEMV 300 mg concentrate for solution for infusion, BEKEMV 300 mg concentrate for solution for infusion

Primary endpoint: Primary endpoint including myocardial tissue expression of LAMP2 protein and decrease in left ventricular mass index (LVMI). Evaluation of efficacy associated with RP-A501.
Endpoint(s): LAMP2 protein expression, LVMI, hsTnI, NT-proBNP, KCCQ, and NYHA class. Evaluation of efficacy associated with RP-A501., Event free survival with events defined as death, heart transplant, mechanical circulatory support (MCS) or heart failure hospitalization. Evaluation of efficacy associated with RP-A501., Incidence, severity and duration of treatment emergent safety events. Evaluation of safety.

Source: https://euclinicaltrials.eu/ctis-public/view/2023-506480-34-00